EU clinical trial 2024-518195-31-00: AMUNDSEN - Acute Myocardial infarction Upbound to percutaneous coronary intervention, immediately (STEMI) or in the Next three Days (NSTEMI), and randomized to Subcutaneous Evolocumab or Normal strategies to reach guidelines LDL objectives in the real-world - The AMUNDSEN-real trial-
Protocol code: APHP201075
Sponsor: Assistance Publique Hopitaux De Paris (Hospital/Clinic/Other health care facility). Phase: Therapeutic use (Phase IV). Countries: Spain (authorised, recruiting), Germany (authorised, recruiting), Poland (authorised, recruiting), France (authorised, recruiting), Italy (authorised, recruiting).
Therapeutic area(s): Diseases [C] - Cardiovascular Diseases [C14]
Gender: Female, Male. Age: 18-64 years. Enrolment: 2166.
Status: Authorised, recruiting. Start date (EU): 2021-09-29. Decision date: 2024-11-12. Results received: No. Last updated: 2025-12-05.
Decision dates by country: ES: 2024-11-11, PL: 2024-11-14, DE: 2024-11-15, FR: 2025-05-23, IT: 2024-12-16

Condition(s): acute myocardial infarction
Product: Repatha 140 mg solution for injection in pre-filled pen

Primary endpoint: The primary endpoint is a reduction in LDL-C levels ≥ 50% from baseline and an LDL-C level < 1.4 mmol/L at 12 months follow-up., LDL-C levels will be assessed at follow-up visits at 6 and 22 weeks and 12 months after randomisation. (At 38 weeks, 16, 20, 28 and 32 months post-randomisation, only if data are available)., The primary clinical endpoint is the composite endpoint of death (any cause) or any unplanned hospitalization for a CV reason at 12 months
Endpoint(s): LDL-C<40, mg/dL at 12 months follow-up, Composite of death (any cause), myocardial infarction, stroke, unplanned revascularization at 12 months follow-up, Composite of death (any cause) or myocardial infarction at 12 months follow-up, Death (any cause) at 12 months follow-up, Death (cardiovascular) at 12 months follow-up, Composite of death (any cause), myocardial infarction, stroke at 12 months follow-up

Source: https://euclinicaltrials.eu/ctis-public/view/2024-518195-31-00